EU clinical trial 2025-522243-17-00: A Phase I study to evaluate the safety and efficacy of L19IL2 in combination with ruxolitinib in patients with advanced solid tumors.
Protocol code: PH-L19IL2CORK-01/25
Sponsor: Philogen S.p.A. (Pharmaceutical company). Phase: Human Pharmacology (Phase I)- Other. Countries: Italy (authorised, recruitment pending).
Therapeutic area(s): Diseases [C] - Neoplasms [C04]
Gender: Female, Male. Age: 18-64 years, 65+ years. Enrolment: 96.
Status: Authorised, recruitment pending. Decision date: 2025-12-22. Results received: No. Last updated: 2026-08-05.

Condition(s): Advanced solid tumors, specifically: • metastatic clear cell renal carcinoma; • proficient mismatch repair / microsatellite stable (pMMR/MSS), BRAF-V600E-mutant negative colorectal carcinoma; • locally advanced or metastatic pancreatic adenocarcinoma

Source: https://euclinicaltrials.eu/ctis-public/view/2025-522243-17-00